EU clinical trial 2025-522162-75-00: A single arm phase II study evaluating intracranial efficacy of tarlatamab in patients with asymptomatic active brain metastases from small cell lung cancer
Sponsor: Academisch Ziekenhuis Maastricht (Hospital/Clinic/Other health care facility). Phase: Therapeutic exploratory (Phase II). Countries: Netherlands (authorised, recruitment pending).
Therapeutic area(s): Diseases [C] - Respiratory Tract Diseases [C08]
Gender: Female, Male. Age: 18-64 years, 65+ years. Enrolment: 35.
Status: Authorised, recruitment pending. Decision date: 2026-04-15. Results received: No. Last updated: 2026-04-15.

Condition(s): patients with asymptomatic active brain metastases from small cell lung cancer
Product: Tarlatamab, Tarlatamab

Primary endpoint: - BM ORR (RANO-BM). This will be evaluated with MRI brain after six weeks of treatment and there-after every six weeks. Confirmed BM ORR according to RANO-BM will be measured at 12 weeks.
Endpoint(s): All imaging related endpoints will be measured with MRI brain for BM related outcomes and CT chest and upper abdomen for extracranial related outcomes after six weeks of treatment and thereafter eve-ry six weeks. - Key secondary: BM DCR (RANO-BM), CNS PFS (RANO-BM) - Extracranial ORR and DCR (RECIST 1.1) - extracranial PFS (based on RECIST 1.1) - overall PFS (based on RANO-BM for BM and RECIST 1.1 for extracranial lesions) - OS - Safety according to CTCAE v 5.0 during every visit

Source: https://euclinicaltrials.eu/ctis-public/view/2025-522162-75-00